EU clinical trial 2024-513768-24-00: Effect of cannabidiol on muscle recovery following a single bout of resistance exercise.
Sponsor: UZ Leuven (Hospital/Clinic/Other health care facility). Phase: Human Pharmacology (Phase I)- Other. Countries: Belgium (ended).
Therapeutic area(s): Phenomena and Processes [G] - Physiological processes [G07]
Gender: Male. Age: 18-64 years. Enrolment: 24.
Status: Ended. Start date (EU): 2024-01-29. End date (EU): 2025-10-10. Decision date: 2024-08-14. Results received: No. Last updated: 2024-08-14.

Condition(s): Healthy individuals

Source: https://euclinicaltrials.eu/ctis-public/view/2024-513768-24-00